EU clinical trial 2024-515958-24-00: Preoperative Antibiotics for Mild or Moderate Acute Cholecystitis (POMMAC): A Non-inferiority, Open-label, Randomized Controlled Trial – Study Protocol
Sponsor: HUS-Yhtymae (Hospital/Clinic/Other health care facility). Phase: Therapeutic confirmatory (Phase III). Countries: Finland (ongoing, recruiting).
Therapeutic area(s): Diseases [C] - Digestive System Diseases [C06]
Gender: Female, Male. Age: 18-64 years, 65+ years. Enrolment: 456.
Status: Ongoing, recruiting. Start date (EU): 2025-08-25. Decision date: 2025-04-07. Results received: No. Last updated: 2025-12-05.
Decision dates by country: FI: 2025-04-09

Condition(s): Acute cholecystitis
Product: INVANZ 1 g powder for concentrate for solution for infusion, Ciprofloxacin Fresenius Kabi 2 mg/ml infuusioneste, liuos, Cefuroxime Orion Pharma 1,5 g injektio/infuusiokuiva-aine, liuosta/suspensiota varten

Primary endpoint: The rate of postoperative infectious complications within 30 days from randomisation
Endpoint(s): The conversion rate from laparoscopic to open cholecystectomy during the primary operation, The Comprehensive Complication Index according to the Clavien-Dindo Classification within 30 days postoperatively, A composite outcome incorporating the rate of all antibiotic-related adverse outcomes (hypersensitivity reactions, clostridium difficile diarrhea, yeast infections) within 30 days postoperatively, The length of stay

Source: https://euclinicaltrials.eu/ctis-public/view/2024-515958-24-00